EU clinical trial 2024-513547-82-00: A Phase 3, Randomized, Multicenter, Double-Blind, Placebo-Controlled Study of Acoramidis for Transthyretin Amyloidosis Prevention in the Young (ACT-EARLY Trial)
Protocol code: AG10-501
Sponsor: Eidos Therapeutics Inc. (Pharmaceutical company). Phase: Therapeutic confirmatory (Phase III). Countries: Bulgaria (ended), Portugal (ongoing, recruiting), Germany (ongoing, recruiting), Italy (ongoing, recruiting), Netherlands (ongoing, recruiting), France (ongoing, recruiting), Spain (ongoing, recruiting), Ireland (ongoing, recruiting), Sweden (ongoing, recruiting), Denmark (ongoing, recruiting), Greece (ongoing, recruiting), Belgium (ongoing, recruiting).
Therapeutic area(s): Diseases [C] - Cardiovascular Diseases [C14]; Diseases [C] - Nervous System Diseases [C10]
Gender: Female, Male. Age: 18-64 years, 65+ years. Enrolment: 314.
Start date (EU): 2025-03-11. Decision date: 2025-01-15. Results received: No. Last updated: 2026-07-17.
Decision dates by country: BG: 2025-01-17, DK: 2025-06-13, FR: 2025-01-17, IT: 2025-01-23, IE: 2025-05-23, SE: 2025-05-26, GR: 2025-06-25, DE: 2025-01-23, PT: 2025-01-20, BE: 2025-07-24, NL: 2025-01-20, ES: 2025-01-15

Condition(s): Transthyretin Amyloidosis
Product: Acoramidis Hydrochloride Matching Placebo, Acoramidis (AG10)

Primary endpoint: 1. Time to development of ATTR (ATTR-CM or ATTR-PN, whichever occurs first). For further details, please refer to the protocol.
Endpoint(s): 1. Time to development of ATTR-CM and ATTR-PN. For further details, please refer to the protocol., 2. Participants who develop ATTR as defined in the primary endpoint at the time of study completion (yes/no), 3. Time to development of symptomatic ATTR and ATTR-CM, 4. Participants who develop symptomatic ATTR, 5. Parameters. For further details, please refer to the protocol., 6. Proportion of participants with: treatment-emergent AEs and SAEs, AEs leading to treatment discontinuation, abnormal physical examination findings of clinical relevance, abnormal vital signs of clinical relevance, abnormal ECG parameters of clinical relevance, and changes in clinical safety laboratory parameters of potential concern

Source: https://euclinicaltrials.eu/ctis-public/view/2024-513547-82-00